EU clinical trial 2025-523058-16-00: A Randomized, Placebo-controlled, Parallel Phase 2a Dose-ranging Study to Investigate the Efficacy, Safety, and Tolerability of Topical HT-001 for the Treatment of Skin Toxicities Associated with Epidermal Growth Factor Receptor Inhibitors CLEER Trial (Chemotherapy Longevity by Evading EGFR Inhibitor Reactions)
Protocol code: CLEER-001
Sponsor: Hoth Therapeutics Inc. (Pharmaceutical company). Phase: Therapeutic exploratory (Phase II). Countries: Spain (ended), Hungary (ended), Poland (ended).
Therapeutic area(s): Diseases [C] - Skin and Connective Tissue Diseases [C17]
Gender: Female, Male. Age: 18-64 years, 65+ years. Enrolment: 98.
Status: Ended. Start date (EU): 2026-04-28. End date (EU): 2026-06-17. Decision date: 2026-01-15. Results received: No. Last updated: 2026-05-11.
Decision dates by country: ES: 2026-01-15, PL: 2026-01-19, HU: 2026-01-16

Condition(s): Skin Toxicities Associated with Epidermal Growth Factor Receptor Inhibitors
Product: HT-001, HT-001, The corresponding placebo is formulated using the same excipients as HT-001 and is identical in color and physical appearance., HT-001

Primary endpoint: Part 1 (open-label PK cohort) • Investigating PK parameters including: measured drug concentrations above the lower limit of quantitation, number of participants with measurable systemic exposure; if data allow - area under the curve (AUC), maximum (or peak) concentration (Cmax), and time of peak concentration (Tmax), Part 2 (randomized double-blind cohort) • Proportion of participants with a grade ≤ 1 based on the ARIGA scale after 6 weeks of HT-001 treatment
Endpoint(s): • Change from Baseline in pruritus numeric rating scale (NRS; average itch and worst itch) after 3 weeks and 6 weeks of HT-001 treatment compared to placebo, • Change from Baseline in pain based on an NRS after 3 weeks and 6 weeks of HT-001 treatment compared to placebo, • Change from Baseline in acneiform rash grade based on the ARIGA scale at 3 weeks and 6 weeks of HT-001 treatment compared to placebo, • Time to improvement for at least 1 grade using the ARIGA scale for acneiform rash for HT-001 treatment compared to placebo, • Time to topical rescue therapy treatment after initiation of HT-001 treatment compared to placebo, • Proportion of patients with EGFRI dose reduction or discontinuation due to EGFR inhibitor skin toxicities after 6 weeks of HT-001 treatment compared to placebo, • Safety and tolerability of HT-001 as measured by: o Incidence of treatment-emergent adverse events (TEAEs) and treatment-emergent serious adverse events (SAEs), • Safety and tolerability of HT-001 as measured by: o Skin irritation, as assessed using the modified Draize Scale to evaluate cutaneous signs of erythema and edema, • Safety and tolerability of HT-001 as measured by: o Physical examinations, • Safety and tolerability of HT-001 as measured by: o Vital signs, • Safety and tolerability of HT-001 as measured by: o 12-lead electrocardiograms (ECG), • Safety and tolerability of HT-001 as measured by: o Clinical laboratory values (hematology, chemistry, urinalysis), including transaminase and bilirubin levels

Source: https://euclinicaltrials.eu/ctis-public/view/2025-523058-16-00